EU clinical trial 2024-513460-26-00: A Phase 3, 52-Week, Randomized, Double-Blind, Placebo-Controlled, Parallel-Arm Efficacy and Safety Study with Open-Label Extension of BLU-5937 in Adult Participants with Refractory Chronic Cough, Including Unexplained Chronic Cough (CALM-1)
Protocol code: BUS-P3-01
Sponsor: Bellus Health Inc. (Pharmaceutical company). Phase: Therapeutic confirmatory (Phase III). Countries: Netherlands (ended), Poland (ended), Belgium (ended), Spain (ended), Hungary (ended), France (ended).
Therapeutic area(s): Diseases [C] - Respiratory Tract Diseases [C08]
Gender: Female, Male. Age: 18-64 years, 65+ years. Enrolment: 275.
Status: Ended. Start date (EU): 2023-03-29. End date (EU): 2026-06-15. End date: 2026-06-18. Decision date: 2024-09-24. Results received: No. Last updated: 2025-12-04.
Decision dates by country: PL: 2024-09-25, BE: 2024-09-25, FR: 2024-11-28, NL: 2024-09-24, HU: 2024-09-25, ES: 2024-09-27

Condition(s): Refractory Chronic Cough, Including Unexplained Chronic Cough
Product: Tablets are round, biconvex, plain and white to off white, BLU-5937, Tablets are round, biconvex, plain and white to off white

Primary endpoint: 24-hour cough frequency at Week 12 by a cough monitor. • Incidence of AEs and SAEs up to Week 52 • Incidence of AEMIs up to Week 52 • Occurrences of study treatment discontinuations due to AEs and SAEs up to Week 52 • Occurrences of AEs and SAEs leading to study withdrawal up to Week 52
Endpoint(s): CS-VAS • Change from Baseline in CS-VAS at Week 12 • CS-VAS response at Week 12 Objective cough frequency recording • Awake cough frequency at Week 12 • 24-hour cough response at Week 12 LCQ • Change from Baseline in the LCQ total score at Week 12 • LCQ response at Week 12

Source: https://euclinicaltrials.eu/ctis-public/view/2024-513460-26-00